EU clinical trial 2024-511537-35-00: An open-label, multicentre, integrated Phase 1 & 2 study to evaluate the safety, tolerability, radiation dosimetry and anti-tumour activity of Lutetium (177Lu) rhPSMA-10.1 injection in men with metastatic castrate-resistant prostate cancer
Protocol code: BET-PSMA-121
Sponsor: Blue Earth Therapeutics Limited (Pharmaceutical company). Phase: Phase I and Phase II (Integrated)- Other. Countries: Germany (ongoing, recruiting), Belgium (ongoing, recruiting), Netherlands (ongoing, recruiting).
Therapeutic area(s): Diseases [C] - Neoplasms [C04]
Gender: Male. Age: 18-64 years, 65+ years. Enrolment: 45.
Status: Ongoing, recruiting. Start date (EU): 2024-02-09. Decision date: 2024-07-11. Results received: No. Last updated: 2026-07-06.
Decision dates by country: NL: 2024-07-11, DE: 2024-07-16, BE: 2024-07-16

Condition(s): Metastatic castration-resistant prostate cancer (mCRPC)
Product: Lutetium (177Lu) rhPSMA-10.1 injection

Primary endpoint: Phase 1: 1. Incidence of DLTs during the DLT observation period. The definition of DLTs in this study is described in protocol section 4.1.1.4., Phase 1: 2. Frequency and nature of treatment-emergent adverse events (TEAEs)., Phase 2: Proportion of subjects with an anti-tumour response defined as a ≥50% reduction in PSA level from baseline to the End of Treatment (EoT).
Endpoint(s): Phase 1: 1. Terminal half-life of activity concentrations in blood., Phase 1: 2. Specific whole-body absorbed dose (Gy/GBq), specific absorbed dose to the tumour lesions (Gy/GBq), specific absorbed dose per organ (Gy/GBq) and cumulative absorbed organ and whole-body absorbed doses (Gy)., Phase 1: 3. Number of subjects with ≥50% reduction in PSA level from baseline at 12 weeks after first therapeutic IMP administration., Phase 1: 4. Number of subjects with best response in PSA level ≥50% from baseline to the end of the dosing period., Phase 1: 5. PSA Progression-free survival (PFS): Time interval from first cycle of therapeutic IMP administration to PSA progression as defined by the Prostate Cancer Clinical Trials Working Group 3 (PCWG3) criteria, or death, whichever comes first., Phase 1: 6. Number of subjects who remain PSA progression-free at fixed 6-month intervals throughout the study., Phase 1: 7. Duration of response as defined by time interval from achieving a ≥50% reduction in PSA compared to baseline to the PSA returning to baseline or evidence of radiological progression, as defined by PCWG3, or death., Phase 1: 8. Radiographic PFS (rPFS): Time interval from first therapeutic IMP administration to the date when the first site of disease is found to progress radiographically, or death, whichever occurs first, as defined by PCWG3., Phase 1: 9. Number of subjects who remain radiographic progression-free at fixed 6-month intervals throughout the study., Phase 1: 10. Number of subjects with confirmed complete response (CR) or partial response (PR) based on PCWG3-recommended application of the Response Evaluation Criteria in Solid Tumours v1.1 (RECIST v1.1) criteria., Phase 1: 11. Evaluation of PSMA PET/CT defined disease response after 2 treatment cycles., Phase 1: 12. Overall survival at fixed 6 month intervals throughout the study., Phase 1: 13. Time to PSA progression: Time interval from first cycle of therapeutic IMP administration to PSA progression as defined by the PCWG3 criteria., Phase 1: 14. Time to radiographic progression: Time interval from first therapeutic IMP administration to the date when the first site of disease is found to progress radiographically as defined by PCWG3., Phase 2: 1. Proportion of subjects with ≥50% reduction in PSA level from baseline at 12 weeks after first IMP administration., Phase 2: 2. PSA PFS: Time interval from first cycle of IMP administration to PSA progression as defined by PCWG3 criteria, or death., Phase 2: 3. Proportion of subjects who remain PSA progression-free at fixed 6-month intervals throughout the study., Phase 2: 4. Duration of response as defined by time interval from achieving a ≥50% reduction in PSA compared to baseline to the PSA returning to baseline or evidence of radiological progression, as defined by PCWG3., Phase 2: 5. Radiographic PFS: Time interval from first cycle of IMP administration to the date when the first site of disease is found to progress radiographically, or death, whichever occurs first, as defined by PCWG3., Phase 2: 10. Proportion of subjects who remain radiographic progression-free at fixed 6-month intervals throughout the study., Phase 2: 11. Proportion of subjects with confirmed CR or PR based on PCWG3-recommended application of RECIST v1.1., Phase 2: 12. Overall survival, defined as the time interval from first cycle of IMP administration to death., Phase 2: 13. Overall survival at fixed 6-month intervals throughout the study., Phase 2: 14. Time to PSA progression: Time interval from first cycle of IMP administration to PSA progression as defined by PCWG3 criteria., Phase 2: 15. Time to radiographic progression: Time interval from first cycle of IMP administration to the date when the first site of disease is found to progress radiographically as defined by PCWG3., Phase 2: 16. Frequency and nature of TEAEs., Phase 2: 17. Specific absorbed dose to the tumour lesions (Gy/GBq), specific absorbed dose per organ (Gy/GBq)., Phase 2: 18. Changes in patient-reported outcomes (PROs) assessed by FACT-P. The PROs will be measured from baseline up to the EoT: • Change from baseline in FACT-P total score. • Proportion of subjects with improvement or worsening in the FACT-P total score and subscales. • Time to worsening in the FACT-P total score and subscales, defined as the time from first cycle of IMP administration to worsening, clinical progression, or death, whichever occurs first., Phase 2: 6. Time to radiographic progression, any subsequent anti-cancer therapy, or death: Time interval from first IMP administration to the date when the first site of disease is found to progress radiographically, as defined by PCWG3, initiation of subsequent anti-cancer therapy, or death from any cause, whichever occurs first., Phase 2: 7. Time to any subsequent anti-cancer therapy or death: Time interval from first IMP administration to the initiation of any subsequent anti-cancer therapy or death from any cause, whichever occurs first., Phase 2: 8. Time from first IMP administration to radiographic progression per PCWG3, or unconfirmed radiographic progression not followed by imaging demonstrating non-progressive disease, or death from any cause, whichever occurs first., Phase 2: 9. Time to chemotherapy or death: Time interval from first cycle of IMP administration to the initiation of chemotherapy or death from any cause, whichever occurs first.

Source: https://euclinicaltrials.eu/ctis-public/view/2024-511537-35-00